EU clinical trial 2023-508506-22-00: A multicentre trial evaluating the efficacy and safety of oral decitabine-tetrahydrouridine (NDec) in patients with sickle cell disease
Protocol code: NN7533-4470
Sponsor: Novo Nordisk A/S (Pharmaceutical company). Phase: Therapeutic exploratory (Phase II). Countries: France (ended), Italy (ended), Greece (ended), Spain (ended).
Therapeutic area(s): Diseases [C] - Hemic and Lymphatic Diseases [C15]
Gender: Female, Male. Age: 18-64 years, 65+ years. Enrolment: 15.
Status: Ended. Start date (EU): 2022-09-22. End date (EU): 2025-05-07. End date: 2025-07-24. Decision date: 2024-06-28. Results received: Yes. Last updated: 2024-12-19.
Decision dates by country: FR: 2024-07-05, GR: 2024-07-22, ES: 2024-06-28, IT: 2024-07-08

Condition(s): Sickle cell disease
Product: Decitabine/Tetrahydrouridine A 5/250 mg, Siklos 1 000 mg film-coated tablet., Placebo (NDec)

Primary endpoint: Change from baseline (week 0) to week 24 in total haemoglobin in g/dL
Endpoint(s): Cmax (maximum concentration) for decitabine from pharmacokinetic assessment At week 24 in ng/mL, Cmax (maximum concentration) for tetrahydrouridine from pharmacokinetic assessment at week 24 in ng/mL, Change in DNMT1 activity From baseline (week 0) to week 24 in MFI, Change in CDA activity From baseline (week 0) to week 24 in µmol/L/min, Change in foetal haemoglobin (g/dL) From baseline (week 0) to week 24 in g/dL, Change in foetal haemoglobin as a proportion of total haemoglobin (%HbF) From baseline (week 0) to week 24 in %, Change in F-cell level as a proportion of total red blood cells (%F-cells) From baseline (week 0) to week 24 in %, Change in haemolysis measure: absolute reticulocyte count From baseline (week 0) to week 24 in cells × 10^9/L, Change in haemolysis measure: indirect bilirubin From baseline (week 0) to week 24 in mg/dL, Change in haemolysis measure: lactate dehydrogenase From baseline (week 0) to week 24 in U/L, Number of vaso-occlusive crises From baseline (week 0) to week 48 in Number of events, Number of acute chest syndrome From baseline (week 0) to week 48 in Number of events, Number of RBC units transfused From baseline (week 0) to week 48 in units, Number of adverse events of grade 3 or higher From baseline (week 0) to week 52 in Number of events

Source: https://euclinicaltrials.eu/ctis-public/view/2023-508506-22-00